EU clinical trial 2022-502931-20-00: A randomized controlled trial to evaluate the efficacy, acceptability and safety of event-driven pre-exposure prophylaxis for HIV using TAF/FTC in men who have sex with men in Thailand and France
Protocol code: ANRS 0029s SimpPrEP
Sponsor: Inserm (Laboratory/Research/Testing facility). Phase: Therapeutic confirmatory (Phase III). Countries: France (ongoing, recruiting).
Therapeutic area(s): Diseases [C] - Virus Diseases [C02]
Gender: Male. Age: 18-64 years, 65+ years. Enrolment: 210.
Status: Ongoing, recruiting. Start date (EU): 2024-07-22. Decision date: 2023-03-15. Results received: No. Last updated: 2026-06-26.
Decision dates by country: FR: 2023-05-31

Condition(s): HIV prevention

Source: https://euclinicaltrials.eu/ctis-public/view/2022-502931-20-00